EU clinical trial 2022-502576-23-00: A trial to learn if AZD5335 alone and in combination with other treatments is safe and effective and how it moves through the body in people with solid tumors
Protocol code: D8990C00001
Sponsor: AstraZeneca AB (Pharmaceutical company). Phase: Human Pharmacology (Phase I)- First administration to humans. Countries: Spain (ongoing, recruiting), Germany (ongoing, recruiting).
Therapeutic area(s): Diseases [C] - Neoplasms [C04]
Gender: Female, Male. Age: 18-64 years, 65+ years. Enrolment: 70.
Status: Ongoing, recruiting. Start date (EU): 2024-04-17. Decision date: 2024-01-22. Results received: No. Last updated: 2026-03-02.
Decision dates by country: DE: 2024-12-17, ES: 2024-01-22

Condition(s): Platinum-resistant recurrent (PRR) ovarian cancer, Platinum-sensitive recurrent (PSR) ovarian cancer, Lung Adenocarcinoma, and endometrial cancer.

Source: https://euclinicaltrials.eu/ctis-public/view/2022-502576-23-00